EU clinical trial 2025-521130-28-00: Efficacy and Safety of Nipocalimab vs Efgartigimod in a Randomized, Open-label, Phase 3b, Interventional Trial Including Within Class Switching From Efgartigimod to Nipocalimab
Protocol code: 80202135MYG3002
Sponsor: Janssen Cilag International (Pharmaceutical company). Phase: Therapeutic confirmatory (Phase III). Countries: Austria (authorised, recruitment pending), Germany (authorised, recruitment pending), Spain (authorised, recruitment pending), Italy (authorised, recruitment pending).
Therapeutic area(s): Diseases [C] - Immune System Diseases [C20]
Gender: Female, Male. Age: 18-64 years, 65+ years. Enrolment: 29.
Status: Authorised, recruitment pending. Decision date: 2025-12-10. Results received: No. Last updated: 2026-06-09.
Decision dates by country: AT: 2025-12-14, DE: 2025-12-12, IT: 2025-12-11, ES: 2025-12-10

Condition(s): generalized myasthenia gravis
Product: JNJ-80202135, EFGARTIGIMOD ALFA

Primary endpoint: Averaged mean percent change from baseline in total IgG over Weeks 8 to 12 between Arms 1 and 2.

Source: https://euclinicaltrials.eu/ctis-public/view/2025-521130-28-00